EU clinical trial 2024-518093-13-00: Prospective evaluation of the efficacy and safety of topical hydrocortisone treatment on clinical signs and symptoms of dry eye disease associated with moderate meibomian gland dysfunction
Protocol code: THEA_HLF_1/21
Sponsor: Laboratorios Thea S.A. (Pharmaceutical company). Phase: Therapeutic use (Phase IV). Countries: Spain (ended).
Therapeutic area(s): Diseases [C] - Eye Diseases [C11]
Gender: Female, Male. Age: 18-64 years, 65+ years. Enrolment: 54.
Status: Ended. Start date (EU): 2021-10-26. End date (EU): 2025-07-16. Decision date: 2024-10-21. Results received: Yes. Last updated: 2024-10-21.

Condition(s): Dry Eye and Meibomian Gland Dysfunction
Product: Softacort 3,35 mg/ml colirio en solución en envases unidosis

Primary endpoint: Efficacy: Change in MGD-DE symptom score from D0 to D14., Exploratory: Change from D0 value to D14 (both eyes) in level of the following inflammatory cytokines in tears: IL-6, TNF alpha, IL-1b, IL-10, IFNγ, IL-17A, IL-2, IL-4. First eye to sample will be the study eye., Safety: Incidence of increased intraocular pressure (IOP). Change in IOP between D0, D14, D28 and D84.
Endpoint(s): Efficacy: Ocular Symptoms • Change in OSDI score between D0 and D14, D28 and D84. • Change in MGD-DE symptom score from D0 to D28 and D84. • Change in VAS score of each of 7 symptoms (itching, dry eye sensation, burning, foreign body sensation, ocular redness, ocular fatigue, and blurry vision) between D0 and D14, D28 and D84., Efficacy: Ocular signs of DED • Change in hyperemia score (McMonnies – Chapman scale) between D0 and D14, D28 and D84. • Change in TBUT between D0 and D14, D28 and D84. • Change in corneal and conjunctival staining with fluorescein (Oxford grading scale) between D0 and D14, D28 and D84. • Change in corneal and conjunctival staining with lissamine green (Van Bijsterveld scale) between D0 and D14, D28 and D84. • Change in Schirmer I test between D0 and D14, D28 and D84., Efficacy: Ocular signs of MGD • Change in grading of MGD according to a graduation from 0 to 4 between D0 and D84. • Change in lid abnormality score according to a graduation from 0 to 2, where 0 is no findings and 2 is severe findings, between D0 an, Safety: • Incidence of adverse events (AE) and serious adverse events (SAE) occurred during the study. • Change in visual acuity between D0, D14, D28 and D84. Early Treatment Diabetic Retinopathy Study (ETDRS) scale will be used.

Source: https://euclinicaltrials.eu/ctis-public/view/2024-518093-13-00